EU clinical trial 2025-522930-29-00: A Trial to Examine the Effects of MSP-2020 on Brain Activity in Healthy Adults
Protocol code: 358-201-00001
Sponsor: Otsuka Pharmaceutical Development & Commercialization Inc. (Pharmaceutical company). Phase: Human Pharmacology (Phase I)- Other. Countries: Netherlands (temporarily halted).
Therapeutic area(s): Psychiatry and Psychology [F] - Mental Disorders [F03]
Gender: Female, Male. Age: 18-64 years. Enrolment: 72.
Status: Temporarily halted. Start date (EU): 2025-11-17. Decision date: 2025-10-31. Results received: No. Last updated: 2026-05-27.

Condition(s): Incomplete Response - Major Depressive Disorder (IR-MDD)

Source: https://euclinicaltrials.eu/ctis-public/view/2025-522930-29-00